EU clinical trial 2025-521075-31-00: RANDOMIZED CONTROLLED STUDY COMPARING SUFENTANIL AND KETAMINE INTRANASALLY IN THE MANAGEMENT OF SEVERE ACUTE TRAUMA-RELATED PAIN IN CHILDREN
Protocol code: 24-HPNCL-03
Sponsor: Fondation Lenval Nice (Patient organisation/association). Phase: Therapeutic exploratory (Phase II). Countries: France (ongoing, recruiting).
Therapeutic area(s): Analytical, Diagnostic and Therapeutic Techniques and Equipment [E] - Anesthesia and Analgesia [E03]
Gender: Female, Male. Age: 0-17 years. Enrolment: 116.
Status: Ongoing, recruiting. Start date (EU): 2026-02-03. Decision date: 2025-09-30. Results received: No. Last updated: 2025-09-30.

Condition(s): SEVERE ACUTE TRAUMA-RELATED PAIN
Product: EMLA® 5 POUR CENT, crème, NALOXONE AGUETTANT 0,4 mg/ml, solution injectable, ENTONOX 170 bar, gaz pour inhalation, en bouteille, KETAMINE PANPHARMA 50 mg/mL, solution injectable (I.V.-I.M.), SUFENTA 250 microgrammes/5 ml, solution injectable (I.V. ou péridurale) en ampoule

Primary endpoint: The effectiveness of the treatments will be assessed by evaluating pain. The intensity of pain will be measured using the vertical visual analog scale (VAS). Effectiveness will be defined as the change in pain intensity measured between the initial time (T0), when the treatment is administered, and the 30th minute (T30). Thus, we will define ∆intensity = IntensityT30 – IntensityT0.The average change in intensity will be compared between the groups.
Endpoint(s): The analgesic action time will be defined as the measure of the elapsed time (in minutes) between the administration of the treatment and the achievement of a pain score considered effective. This score is defined as a reduction of at least 20 mm on the initial visual analog scale score (T0). Therefore, the pain will be assessed every 5 minutes for up to 30 minutes, in order to precisely determine the moment of achieving control., The assessment of sedation in each treatment group will be carried out using the Ramsay scale.The degree of sedation will be evaluated every 5 minutes after the intranasal injection of the study treatment until 30 minutes, and then every 10 minutes until 60 minutes post-injection.A patient will be defined as being in excessive sedation if the score is > 3., The evaluation of treatment tolerance will be carried out by collecting the number and nature of the adverse effects reported by patients in each group. The rate of occurrence of an adverse effect will be compared between the two groups to determine whether one of the treatments is associated with a higher frequency of this adverse effect., The evaluation of parent satisfaction will be carried out by a closed question asked at the end of the intervention, at 60 minutes: "Are you satisfied with your child's pain management?", possible answers: "Satisfied", "Not satisfied", "No opinion"., Children's satisfaction will be assessed using a Likert-type questionnaire with a smiley scale before the age of 10, and after the age of 10, a validated PREM (Patient Reported Experience Measure) questionnaire of 25 questions, specifically adapted for pediatric emergencies. Either of the questionnaires will be offered 60 minutes after the end of care, for immediate feedback, without disrupting the care process., The consumption of additional analgesics will be evaluated in the form of binary parameters (yes/no). It will be clearly distinguished whether this consumption occurred before or after T0. Three distinct categories (Level I, Level II, MEOPA) and the reasons justifying the administration of additional analgesics will be documented. The time before the administration of an additional analgesic will be collected and analyzed.

Source: https://euclinicaltrials.eu/ctis-public/view/2025-521075-31-00